EU clinical trial 2024-512913-42-00: A Phase 2a, Randomized, Double-Blind, Placebo-Controlled, Multicenter, Dose-Escalation, Proof-of-Concept Study Evaluating the Safety, Tolerability, Efficacy and Pharmacokinetics of INT-787 in Subjects with Severe Alcohol-Associated Hepatitis
Protocol code: 787-201
Sponsor: Intercept Pharmaceuticals Inc. (Pharmaceutical company). Phase: Therapeutic exploratory (Phase II). Countries: France (ended).
Therapeutic area(s): Diseases [C] - Nutritional and Metabolic Diseases [C18]
Gender: Female, Male. Age: 18-64 years, 65+ years. Enrolment: 12.
Status: Ended. Start date (EU): 2023-08-21. End date (EU): 2026-03-31. Decision date: 2024-05-22. Results received: No. Last updated: 2025-11-28.

Condition(s): Severe Alcohol-Associated Hepatitis
Product: Placebo

Primary endpoint: Marker of Efficacy - Lille score (response) at Day 7

Source: https://euclinicaltrials.eu/ctis-public/view/2024-512913-42-00